EU clinical trial 2025-524717-86-00: C6461016 - A PHASE 2/3 INTERVENTIONAL STUDY OF PF-08634404 IN COMBINATION WITH CHEMOTHERAPY IN TREATMENT-NAÏVE PARTICIPANTS WITH LOCALLY ADVANCED OR METASTATIC GASTRIC, GASTROESOPHAGEAL JUNCTION, OR ESOPHAGEAL ADENOCARCINOMA
Protocol code: C6461016
Sponsor: Pfizer Inc. (Pharmaceutical company). Phase: Phase II and Phase III (Integrated). Countries: France (authorised, recruitment pending), Spain (authorised, recruitment pending), Italy (authorised, recruitment pending).
Therapeutic area(s): Diseases [C] - Neoplasms [C04]
Gender: Female, Male. Age: 18-64 years, 65+ years. Enrolment: 91.
Status: Authorised, recruitment pending. Decision date: 2026-07-07. Results received: No. Last updated: 2026-07-30.
Decision dates by country: FR: 2026-07-30, IT: 2026-07-07, ES: 2026-07-22

Condition(s): LOCALLY ADVANCED OR METASTATIC GASTRIC, GASTROESOPHAGEAL JUNCTION, OR ESOPHAGEAL ADENOCARCINOMA
Product: NIVOLUMAB, PF-08634404, SODIUM CHLORIDE, CAPECITABINE, CAPECITABINE, FLUOROURACIL, OXALIPLATIN, CALCIUM FOLINATE

Primary endpoint: Phase 2; Confirmed objective response rate (ORR) using Response Evaluation Criteria in Solid Tumors (RECIST) as assessed by investigator, Phase 2; Adverse events (AEs) as characterized by type, frequency, severity (as graded by National Cancer Institute [NCI] Common Terminology Criteria for Adverse Events [CTCAE] version 5.0), timing, seriousness, and relationship to study intervention, Phase 3; PFS using RECIST 1.1 as assessed by BICR, Phase 3; OS
Endpoint(s): Phase 2; - Duration of response (DOR) using RECIST 1.1 as assessed by investigator - Progression-free survival (PFS) using RECIST 1.1 as assessed by investigator - Overall survival (OS), Phase 2; Laboratory abnormalities as characterized by type, frequency, severity (as graded by NCI CTCAE version 5.0), and timing, Phase 2; Predose and postdose concentrations of PF-08634404, Phase 2; Incidence of anti-drug antibodies (ADA) against PF-08634404, Phase 3; - ORR using RECIST 1.1 as assessed by BICR and by investigator - PFS using RECIST 1.1 as assessed by investigator - DOR using RECIST 1.1 as assessed by BICR and by investigator - PFS2 (PFS after, Phase 3; - AEs as characterized by type, frequency, intensity as graded by NCI CTCAE version 5.0, timing, seriousness, and relationship to study intervention(s) - Laboratory test abnormalities as characterized by type, frequency, severity (as graded by NCI CTCAE version 5.0) and timing, Phase 3; Predose and postdose concentrations of PF-08634404, Phase 3; Incidence of ADA against PF- 08634404, Phase 3; - Change from baseline in Functional Assessment of Cancer Therapy – Gastric (FACT-Ga) Total score and Gastric Cancer Subscale (GaCS) score - Time to definitive deterioration in FACT-Ga total score - Time to definitive deterioration in Gastric

Source: https://euclinicaltrials.eu/ctis-public/view/2025-524717-86-00